EU clinical trial 2024-515525-28-00: Hepatic arterial infusion PUMP chemotherapy combined with systemIc chemoTherapy for potentially resectable colorectal liver metastases. - The PUMP-IT study (M19PIT)
Sponsor: Het Nederlands Kanker Instituut-Antoni van Leeuwenhoek Ziekenhuis Stichting (Hospital/Clinic/Other health care facility). Phase: Phase II and Phase III (Integrated). Countries: Netherlands (ongoing, recruitment ended).
Therapeutic area(s): Analytical,Diagnostic,Therapeutic Techniques and Equipment [E]-Surgical Procedures, Operative [E04]; Diseases [C] - Neoplasms [C04]
Gender: Female, Male. Age: 18-64 years, 65+ years. Enrolment: 31.
Status: Ongoing, recruitment ended. Start date (EU): 2020-09-10. Decision date: 2024-11-27. Results received: No. Last updated: 2024-11-27.

Condition(s): colorectal adenocarcinoma
Product: Irinotecan HCl-trihydraat Fresenius Kabi 20 mg/ml, concentraat voor oplossing voor infusie, Folinezuur Sandoz 10 mg/ml, oplossing voor injectie, 5-Fluorouracil Sandoz 50 mg/ml koncentrátum oldatos infúzióhoz, Oxaliplatine Fresenius Kabi 5 mg/ml concentraat voor oplossing voor infusie

Primary endpoint: The primary endpoint of this feasibility study is feasibility, presented as the percentage of in-cluded patients scheduled for surgery which can be treated with at least 2 cycles of HAIP chemotherapy combined with concomitant systemic chemotherapy.
Endpoint(s): Safety: postoperative complications (defined according to Clavien-Dindo surgical complications score. Complications of Clavien-Dindo grade 3 or higher are recorded for the first 90 days after surgery. Postoperative complications include those related to the HAIP implantation. Postoperative mortality id defined as any death during hospitalization or within 90 days from surgery., Safety: Drug treatment toxicity Toxicity grade 3 or higher will be recorded from the time of study inclusion according to the CTCAE version 5.0, Safety: Other adverse events Treatment related serious adverse events (SAE) and adverse events (AE) of grade 3 or higher will be collected continuously from the time of study inclusion until the end of combined chemotherapy.AE are followed up until the event is either resolved or adequately explained, even after the patient has completed his/her study treatment. Nature and duration of any hospitalization, treatment of any AE, and nature and duration of any outpatient care will be recorded., Response rates of CRLM will be measured according to RECIST 1.1 criteria version 5.0, PFS will be defined from inclusion date until disease progression., OS will be defined from inclusion date until death., Conversion rate is defined as the percentage of patients in whom CRLM convert from an unresectable to a resectable state and undergo surgical treatment with curative intent. Possibility of local treatment is at the discretion of the multidisciplinary liver panel.

Source: https://euclinicaltrials.eu/ctis-public/view/2024-515525-28-00